EU clinical trial 2023-505020-57-00: A Phase 2a Randomized, Double-blind, Placebo-controlled Trial with Open-label Dose-finding Cohorts to Evaluate the Efficacy and Safety of CR9114 Monoclonal Antibody Administered as Intranasal Doses in Healthy Adult Participants who are Challenged with a Live, Wild-type Influenza Type A Virus (A/Belgium/4217/2015 H3N2)
Protocol code: F21-CLD-201
Sponsor: Leyden Laboratories B.V. (Laboratory/Research/Testing facility). Phase: Therapeutic exploratory (Phase II). Countries: Belgium (ended).
Therapeutic area(s): Phenomena and Processes [G] - Metabolism [G03]
Gender: Female, Male. Age: 18-64 years. Enrolment: 140.
Status: Ended. Start date (EU): 2023-07-10. End date (EU): 2024-01-23. Decision date: 2023-07-07. Results received: Yes. Last updated: 2023-11-28.

Condition(s): Influenza virus
Product: CR9114, Wild-Type A Influenza Virus A/Belgium/4217/2015 (H3N2), CR9114 Placebo, Nasal Solution

Primary endpoint: Incidence of MMIDa as measured by the InFLUenza Patient Reported Outcome (FLU-PRO) Plus©., Frequency and severity of treatment-emergent adverse events (TEAE) and SAEs.
Endpoint(s): Area under the curve (AUC) of the influenza ribonucleic acid (RNA) log10 viral load, Peak influenza RNA log10 viral load, and influenza RNA log10 viral load actual values by time/visit by real-time quantitative reverse transcription PCR (qRT-PCR) starting on the second day after challenge (Day 3) until discharge (Day 11)., Proportion of participants with infection following challenge virus inoculation as determined by qRT-PCR. Infection is defined as at least 2 consecutive qRT-PCR positive nasopharyngeal swabs starting on the second day after challenge (Day 3)., Viral shedding duration by qRT-PCR and qCulture., Viral shedding quantitation by qRT-PCR and qCulture., Symptom duration/time to onset of symptoms/time to symptom resolution/time to peak symptoms/peak symptom score/total clinical symptom score by day/FLU-PRO domain/system score as measured by the FLU-PRO Plus©., Total number of symptoms experienced with or without laboratory-confirmed influenza illness as measured by the FLU-PRO Plus© and qRT-PCR., Number of participants with upper respiratory tract infection, lower respiratory tract infection, systemic illness as measured by the FLU-PRO Plus©., Proportion of participants with FLU-PRO Plus© score 3 or higher among participants with and without laboratory-confirmed influenza illness as measured by the FLU-PRO Plus© and qRT-PCR., Proportion of participants without symptoms as measured by the FLU-PRO Plus©., Proportion of participants without laboratory-confirmed influenza as measured by qRT-PCR., PK of CR9114 in serum., Presence of anti-CR9114 Abs in serum.

Source: https://euclinicaltrials.eu/ctis-public/view/2023-505020-57-00